EU clinical trial 2023-509419-10-00: Bioequivalence of Vortioxetine 20 mg Film-Coated Tablets in Healthy Participants Under Fasting Conditions
Protocol code: CFA-1034-1-23
Sponsor: Laboratorios Cinfa S.A. (Pharmaceutical company). Phase: Human Pharmacology (Phase I)- Bioequivalence Study. Countries: Portugal (ended).
Therapeutic area(s): Not possible to specify
Gender: Female, Male. Age: 18-64 years. Enrolment: 24.
Status: Ended. Start date (EU): 2024-05-09. End date (EU): 2024-06-11. Decision date: 2024-05-03. Results received: No. Last updated: 2024-05-03.

Condition(s): No medical condition

Source: https://euclinicaltrials.eu/ctis-public/view/2023-509419-10-00